EU clinical trial 2023-504990-19-00: A Phase 3, multicenter, randomized, double-blind, placebo-controlled study to assess the efficacy, safety, and tolerability of AVP-786 (deudextromethorphan hydrobromide [d6-DM]/quinidine sulfate [Q]) for the treatment of agitation in patients with dementia of the Alzheimer’s type
Protocol code: 20-AVP-786-306
Sponsor: Otsuka Pharmaceutical Development & Commercialization Inc. (Pharmaceutical company). Phase: Therapeutic confirmatory (Phase III). Countries: Greece (ended), Estonia (ended), Bulgaria (ended), Poland (ended), Portugal (ended), Denmark (ended), Germany (ended).
Therapeutic area(s): Diseases [C] - Nervous System Diseases [C10]
Gender: Female, Male. Age: 18-64 years, 65+ years. Enrolment: 267.
Status: Ended. Start date (EU): 2021-04-06. End date (EU): 2024-05-22. End date: 2024-05-23. Decision date: 2024-05-14. Results received: Yes. Last updated: 2024-05-29.
Decision dates by country: BG: 2024-05-16, DK: 2024-05-14, EE: 2024-05-20, DE: 2024-05-17, GR: 2024-05-29, PT: 2024-05-14, PL: 2024-05-16

Condition(s): Agitation in Patients With Dementia of the Alzheimer's Type
Product: AVP-786 matching Placebo, AVP-786, AVP-786

Primary endpoint: The primary efficacy endpoint is the change from baseline to the end of the efficacy period in the CMAI total score.
Endpoint(s): The key secondary efficacy variable is the change from baseline to end of efficacy period in the CGI-S score, as related to agitation. It will be analyzed by the same statistical methodology specified for the analysis of the primary efficacy variable. The procedure to control the overall type I error rate for this key secondary efficacy analysis will be described in the SAP.

Source: https://euclinicaltrials.eu/ctis-public/view/2023-504990-19-00